EU clinical trial 2023-503525-19-00: A multicentre, open-label, non-randomized, phase 1a/1b study of NG 641, a tumour-selective and transgene-expressing adenoviral vector, in combination with nivolumab (or standard of care PD-1 inhibition) in patients with metastatic or advanced epithelial tumours (NEBULA)
Protocol code: NG-641-03
Sponsor: Akamis Bio Limited (Pharmaceutical company). Phase: Human Pharmacology (Phase I)- Other. Countries: Belgium (ended), Spain (ended).
Therapeutic area(s): Diseases [C] - Neoplasms [C04]
Gender: Female, Male. Age: 18-64 years, 65+ years. Enrolment: 85.
Status: Ended. End date (EU): 2023-12-13. Decision date: 2023-05-23. Results received: No. Last updated: 2023-05-29.
Decision dates by country: BE: 2023-05-23, ES: 2023-05-29

Condition(s): Metastatic cancer, Epithelial tumours
Product: KEYTRUDA 25 mg/mL concentrate for solution for infusion, OPDIVO 10 mg/mL concentrate for solution for infusion.

Primary endpoint: Incidence of AEs, SAEs, AEs leading to discontinuation and AEs resulting in death, Incidence of AEs meeting protocol defined DLT criteria
Endpoint(s): ORR according to investigator (phase 1a) and IRR (phase 1b) assessments, and using RECIST v1.1, Median PFS and PFS rates according to investigator (phase 1a) and IRRC assessments (phase 1b), Overall survival rate

Source: https://euclinicaltrials.eu/ctis-public/view/2023-503525-19-00